EU clinical trial 2024-512061-14-00: Pharmacokinetics of apixaban in patients with short bowel syndrome requiring long-term parenteral nutrition.
Sponsor: UZ Leuven (Hospital/Clinic/Other health care facility). Phase: Therapeutic use (Phase IV). Countries: Belgium (ongoing, recruiting).
Therapeutic area(s): Diseases [C] - Digestive System Diseases [C06]
Gender: Female, Male. Age: 18-64 years, 65+ years. Enrolment: 84.
Status: Ongoing, recruiting. Start date (EU): 2021-10-07. Decision date: 2024-05-14. Results received: No. Last updated: 2024-05-14.

Condition(s): short bowel syndrome
Product: APIXABAN, TEDUGLUTIDE

Primary endpoint: To investigate the difference in peak level after two different single dose administrations (2,5 mg and 5 mg) of apixaban between patients with and without short bowel syndrome requiring long-term parenteral nutrition

Source: https://euclinicaltrials.eu/ctis-public/view/2024-512061-14-00